EU clinical trial 2024-516367-80-00: Prospective randomized Phase II trial on Induction Immunochemotherapy followed by surgery or definitive chemoradiation and consolidation Durvalumab (MEDI4736) in resectable and borderline resectable stage IIIA/B NSCLC
Sponsor: Rheinische Friedrich-Wilhelms-Universitaet Bonn (Educational Institution). Phase: Therapeutic exploratory (Phase II). Countries: Germany (ongoing, recruiting).
Therapeutic area(s): Diseases [C] - Neoplasms [C04]
Gender: Female, Male. Age: 18-64 years, 65+ years. Enrolment: 176.
Status: Ongoing, recruiting. Start date (EU): 2025-04-24. Decision date: 2025-02-10. Results received: No. Last updated: 2025-10-10.

Condition(s): resectable and borderline resectable stage IIIA/B NSCLC
Product: DURVALUMAB, Paclitaxel onkovis, 6 mg/ml, Konzentrat zur Herstellung einer Infusionslösung, Cisplatin Teva® 1 mg/ml Konzentrat zur Herstellung einer Infusionslösung, DURVALUMAB, Cisplatin Teva® 1 mg/ml Konzentrat zur Herstellung einer Infusionslösung, Paclitaxel onkovis, 6 mg/ml, Konzentrat zur Herstellung einer Infusionslösung, Vinorelbin NC 10 mg/ml - Konzentrat zur Herstellung einer Infusionslösung, Paclitaxel onkovis, 6 mg/ml, Konzentrat zur Herstellung einer Infusionslösung, Carboplat onkovis 10 mg/ml Konzentrat zur Herstellung einer Infusionslösung

Primary endpoint: 2-year EFS rate is defined as percentage of participants without an event specified as relapse or progression according to RECIST 1.1 criteria, secondary tumor, or death of any cause, whichever occurs first, within 2 years after date of randomization.
Endpoint(s): Changes in QLQ-C30 / QLQ-LC13 symptom scales from date of randomization, Changes in QLQ-C30 functional scales and global health status from date of randomization, Occurrence of adverse events according to CTCAE (V5.0): adverse events grade ≥ 3 (according to NCI CTCAE v5.0), Occurrence of adverse events according to CTCAE (V5.0): SAEs, Occurrence of adverse events according to CTCAE (V5.0): Unexpected AEs, Efficacy will be assessed in terms of: Overall survival (OS) defined as time from randomization until death due to any cause, Efficacy will be assessed in terms of: Progression free survival (PFS) defined as time from randomization to objective disease progression or death by any cause, whichever occurs first, Rate of pathological complete response (pCR), major pathological response (mPR) and R0 in resected participants, Functional response (FDG-PET-CT-scan) to induction therapy prior to thoracotomy / chemoradiation according to RECIST and PERCIST in the whole population and in both arms according to CR, PR, SD and PD, Analysis of the SUVmax response and MTV response on the planning FDG-PET-CT in comparison to the pretreatment FDG-PET-CT, Number of PD-L1 positive tumor cells at screening visit, Rate of participants with <1%, 1-49%, ≥50 % PD-L1 positive tumor cells in the group of stage III NSCLC patients (screened population), Rate of randomized participants who completed the planned treatment, Rate of participants who discontinued study treatment due to adverse event, Rate of participants with events / PD that prevent fulfillment of criteria for randomization / surgery

Source: https://euclinicaltrials.eu/ctis-public/view/2024-516367-80-00